EU clinical trial 2024-518587-12-00: C4531031 - AN INTERVENTIONAL PHASE 2/3, RANDOMIZED, DOUBLE-BLIND, THIRD PARTY-UNBLINDED, PLACEBO-CONTROLLED, PARALLEL-GROUP STUDY TO INVESTIGATE EFFICACY AND SAFETY OF PF-07275315 IN ADULT PARTICIPANTS WITH MODERATE-TO-SEVERE CHRONIC OBSTRUCTIVE PULMONARY DISEASE (COPD)
Protocol code: C4531031
Sponsor: Pfizer Inc. (Pharmaceutical company). Phase: Therapeutic exploratory (Phase II). Countries: Spain (authorised, recruitment pending), Germany (authorised, recruitment pending), Poland (authorised, recruitment pending), Czechia (authorised, recruitment pending), Greece (authorised, recruitment pending), Italy (authorised, recruitment pending), Bulgaria (authorised, recruitment pending), France (authorised, recruitment pending), Hungary (authorised, recruitment pending).
Therapeutic area(s): Diseases [C] - Respiratory Tract Diseases [C08]
Gender: Female, Male. Age: 18-64 years, 65+ years. Enrolment: 318.
Status: Authorised, recruitment pending. Decision date: 2026-06-08. Results received: No. Last updated: 2026-07-29.
Decision dates by country: FR: 2026-06-12, DE: 2026-06-08, GR: 2026-06-09, ES: 2026-06-12, PL: 2026-06-12, BG: 2026-06-12, HU: 2026-07-28, CZ: 2026-06-09, IT: 2026-06-10

Condition(s): MODERATE-TO-SEVERE CHRONIC OBSTRUCTIVE PULMONARY DISEASE (COPD)
Product: PF-07275315, Placebo to PF-07275315

Primary endpoint: Phase 2: Change from baseline (CFB) in pre-bronchodilator (BD) forced expiratory volume in one second (FEV1) at Week 24 compared to placebo., Phase 3: Annualized rate of moderate or severe ECOPD.
Endpoint(s): Phase 2 • Annualized rate of moderate or severe ECOPD. • CFB in pre-BD FEV1 at all time points in SoA during treatment period up to Week 24. • CFB in trough, pre- and post-BD FEV1 at each time point in schedule of activities (SoA) during treatment period up to Week 24., Phase 2 • CFB in trough, pre- and post-BD forced vital capacity (FVC) and FEV1/FVC ratio, % predicted FEV1, % predicted FVC at each time point in SoA during treatment period up to Week 24. • CFB in trough FEV1 responsiveness to BD, at each timepoint in SoA during treatment period up to Week 24., Phase 2: • Incidence and severity of treatment-emergent adverse events (TEAE) throughout Phase 2 part of the study. • Incidence of treatment-emergent serious adverse events (SAE) and TEAEs leading to discontinuation. • Incidence of clinical abnormalities and CFB in clinical laboratory values, electrocardiogram (ECG) measurements, and vital signs., Phase 3 Key Secondary Endpoints • CFB in pre- and post-BD FEV1 at Week 12 and Week 52. • Percentage of participants with ≥4 points improvement from baseline in Saint Georges Respiratory Questionnaire (SGRQ) score at Week 52. • Percentage of participants with ≥2 points improvement from baseline in COPD assessment test (CAT) total score at Week 52., Phase 3 Key Secondary Endpoints • Percentage of participants with ≥2 points improvement from baseline in Evaluating Respiratory Symptoms in COPD (E-RS:COPD) total score at Week 52. • Annualized rate of severe ECOPD. • Annualized rate of exacerbations requiring emergency department visit and/or hospitalization.

Source: https://euclinicaltrials.eu/ctis-public/view/2024-518587-12-00